EU clinical trial 2024-514804-14-00: HALT : Influence of Human Albumin supplementation on kidney dysfunction after Liver Transplantation
Protocol code: 35RC22_9739_HALT
Sponsor: Centre Hospitalier Universitaire De Rennes (Hospital/Clinic/Other health care facility). Phase: Therapeutic use (Phase IV). Countries: France (ongoing, recruiting).
Therapeutic area(s): Diseases [C] - Digestive System Diseases [C06]
Gender: Female, Male. Age: 18-64 years, 65+ years. Enrolment: 400.
Status: Ongoing, recruiting. Start date (EU): 2025-03-26. Decision date: 2025-01-16. Results received: No. Last updated: 2026-05-20.

Condition(s): Liver transplantation
Product: HUMAN ALBUMIN SOLUTION

Primary endpoint: Occurrence of Acute Kindey Injury during the first 7 days after liver transplantation (KDIGO criteria)
Endpoint(s): Occurrence and Severity of each Acute Kindey Injury during the first 7 days after liver transplantation (KDIGO Criteria), Hospital length of stay after liver transplantation defined by standardized checklist of discharged criteria, Postoperative calcineurin inhibitors-induced neurotoxicity at D28, Discontinuation of anticalcineurin inhibitor at D28., Occurrence of postoperative infections at D28, Acute graft rejection (biopsy proved) at D28, Occurrence of early graft dysfunction (Olthoff criteria), Duration of mechanical ventilation at D28, Occurrence of reintubation at D28, Duration of Intensive Care Unit length of stay up to D28, Occurence of Intensive Care Unit readmission after discharge of Intensive Care Unit up to D28, Mortality within the first 28 days following surgery, Defined as a lymphocyte count less than 1.2× 103 cells/µL, Using flow cytometry, Using the Seahorse analyzer measuring mitochondrial respiration, Measured using expression of HLA-DR on peripheral monocytes, plasmatic levels of IL-10, MDSC, RNA seq analysis on peripheral blood mononuclear cell, Plasmatic levels of IL-6

Source: https://euclinicaltrials.eu/ctis-public/view/2024-514804-14-00